EU clinical trial 2022-502316-36-00: MEMENTO-A Phase 3b/4 Randomized, Double-blind, Placebo-controlled Clinical Study to Evaluate Mavacamten in Adults with Symptomatic Obstructive Hypertrophic Cardiomyopathy to assess the impact on Myocardial Structure with Cardiac Magnetic Resonance Imaging (CMR)
Protocol code: CV0271088
Sponsor: Myokardia Inc. (Industry). Phase: Phase III and phase IV (Integrated). Countries: Hungary (ended), Finland (ended), Spain (ended), France (ended), Greece (ended), Italy (ended), Austria (ended), Belgium (ended), Poland (not authorised), Czechia (ended), Germany (ended).
Therapeutic area(s): Diseases [C] - Cardiovascular Diseases [C14]
Gender: Female, Male. Age: 18-64 years, 65+ years. Enrolment: 105.
Status: Ended. End date (EU): 2024-03-15. Decision date: 2024-02-06. Results received: No. Last updated: 2024-02-12.
Decision dates by country: AT: 2024-02-12, BE: 2024-02-09, CZ: 2024-02-09, FI: 2024-02-12, FR: 2024-02-08, DE: 2024-02-07, GR: 2024-02-12, HU: 2024-02-07, IT: 2024-02-06, ES: 2024-02-07, PL: 2024-02-09

Condition(s): Symptomatic Obstructive Hypertrophic Cardiomyopathy
Product: Mavacamten, "MYK-461 Capsules, Placebo is a solid oral dosage form in size 2 gelatin capsules each containing 120 mg of an excipient blend. It is intended as a placebo to match MYK-461 Capsules of all active strengths", Mavacamten, Mavacamten, Mavacamten

Primary endpoint: To evaluate the efficacy of mavacamten on both the reduction in heart wall thickness and upper chamber size at week 48 on cardiac magnetic resonance (CMR).
Endpoint(s): To evaluate the impact of mavacamten treatment: on improvement of heart failure class in symptomatic oHCM (New York Heart Association [NYHA] Functional Class) as well as monitor for other cardiac events as a safety assessment.

Source: https://euclinicaltrials.eu/ctis-public/view/2022-502316-36-00